EU clinical trial 2024-511264-89-00: Phase I/II trial of meclofenamate in progressive MGMT-methylated glioblastoma under temozolomide second-line therapy (MecMeth/ NOA-24)
Protocol code: NEU-201901
Sponsor: Rheinische Friedrich-Wilhelms-Universitaet Bonn (Educational Institution). Phase: Therapeutic exploratory (Phase II). Countries: Germany (ongoing, recruiting).
Therapeutic area(s): Diseases [C] - Neoplasms [C04]
Gender: Female, Male. Age: 18-64 years, 65+ years. Enrolment: 72.
Status: Ongoing, recruiting. Start date (EU): 2022-04-11. Decision date: 2024-05-24. Results received: No. Last updated: 2026-04-13.

Condition(s): Glioblastoma
Product: Meclofenamate 50, Meclofenamate 100, TEMOZOLOMIDE

Primary endpoint: Phase I: Incidence of dose-limiting toxicities (DLTs) during the first 8 weeks/56 days of MFA treatment., Phase II: Progression-free survival (PFS) as measured from the day of randomization until diagnosis of progres-sive disease determined by MRI (RANO criteria) in the local center. In a sensitivity analysis, the PFS analysis does also include patients from phase I who received MFA at the same dose as applied in phase II (PFS measured from day of trial inclusion)
Endpoint(s): Phase I: Progression-free survival (PFS) as measured from the inclusion into the trial until diagnosis of progressive disease determined by MRI (RANO criteria) in the local center., Phase I: Analysis of PFS according to post hoc central refer-ence neuroradiological assessment, Phase I: Overall survival as measured from the day of inclusion into the trial, Phase I: •Assessment of safety beyond 8 weeks MFA treat-ment: Toxicity, i.e. continuous monitoring of AE/SAE/SUSARs, Phase II: Analysis of PFS according to post hoc central refer-ence neuroradiological assessment. PFS analysis including both patients from phase II and patients from phase I who received MFA at the same dose as applied in phase II (PFS measured from day of trial inclusion)., Phase II: Overall survival (OS) as measured from the day of randomization in phase II. A further sensitivity anal-ysis, will also include patients from phase I who re-ceived MFA at the same dose as applied in phase II. In these patients, OS starts from day of inclusion into the trial, Phase II: Assessment of safety: Toxcitiy, i.e. continuous moni-toring of AE/SAE/SUSARs until 3 days after end of therapy, Phase II: Karnofsky performance score (KPS), Quality of life (QoL) throughout the trial and Mini Mental state ex-amination (MMSE).

Source: https://euclinicaltrials.eu/ctis-public/view/2024-511264-89-00